EU clinical trial 2022-500802-16-00: A Randomized Phase 3 Study of Datopotamab Deruxtecan (Dato-DXd) and Pembrolizumab, with or without Platinum Chemotherapy, in Subjects with No Prior Therapy for Advanced or Metastatic PD-L1 TPS<50% Non-squamous Non-small Cell Lung Cancer without Actionable Genomic Alterations (TROPION-Lung07)
Protocol code: DS1062-A-U303
Sponsor: Daiichi Sankyo Inc. (Pharmaceutical company). Phase: Therapeutic confirmatory (Phase III). Countries: Spain (ongoing, recruitment ended), Germany (ongoing, recruitment ended), Belgium (ongoing, recruitment ended), Netherlands (ongoing, recruitment ended), Poland (ongoing, recruitment ended), Greece (ongoing, recruitment ended), Hungary (ongoing, recruitment ended), Italy (ongoing, recruitment ended), Austria (ongoing, recruitment ended), France (ongoing, recruitment ended), Czechia (ongoing, recruitment ended), Portugal (ongoing, recruitment ended), Romania (ongoing, recruitment ended).
Therapeutic area(s): Diseases [C] - Neoplasms [C04]
Gender: Female, Male. Age: 18-64 years, 65+ years. Enrolment: 433.
Status: Ongoing, recruitment ended. Start date (EU): 2023-11-01. Decision date: 2023-04-04. Results received: No. Last updated: 2026-05-05.
Decision dates by country: AT: 2023-04-11, NL: 2023-04-06, PT: 2023-11-16, ES: 2023-04-10, DE: 2023-05-26, CZ: 2023-12-06, RO: 2023-11-06, HU: 2023-04-06, IT: 2023-04-07, GR: 2023-04-06, FR: 2023-04-07, BE: 2023-04-04, PL: 2023-04-11

Condition(s): Advanced or Metastatic PD-L1 TPS <50% Non-squamous Non-small Cell Lung Cancer Without Actionable Genomic Alterations
Product: Datopotamab deruxtecan, KEYTRUDA 25 mg/mL concentrate for solution for infusion, PEMETREXED, CARBOPLATIN, CISPLATIN

Primary endpoint: Progression-Free Survival (PFS) is defined as the time from randomization to the first documented radiographic disease progression or death due to any cause, whichever occurs first. Overall Survival (OS) is defined as the time from randomization to death due to any cause.
Endpoint(s): Objective response rate (ORR) is defined as the proportion of subjects who achieved a Best Overall Response (BOR) of confirmed complete response (CR) or confirmed partial response (PR)., PFS is defined as the time from randomization to the first documented radiographic disease progression or death due to any cause, whichever occurs first., ORR is defined as the proportion of subjects who achieved a BOR of CR or confirmed partial PR., Duration of response (DoR) in a responding subject is defined as the time from the date of the first documentation of objective response (confirmed CR or confirmed PR) to the date of the first radiographic disease progression or death due to any cause, whichever occurs first., Time to response (TTR) is defined as the time from randomization to the date of the first documentation of objective response (confirmed CR or confirmed PR) in responding subjects., Disease Control Rate (DCR) is defined as the proportion of subjects who achieved a BOR of confirmed CR, confirmed PR, or stable disease (SD)., PFS2 is defined as the time from the date of randomization to the first documented disease progression on next-line therapy or death due to any cause, whichever occurs first., The time to deterioration (TTD) is defined as the time from randomization to the first onset of a ≥10-point increase in cough, chest pain, or dyspnea, confirmed by a second adjacent ≥10-point increase from randomization in the same symptom, or confirmed by death within 21 days of a ≥10-point increase from randomization., Treatment emergent adverse events (TEAEs), serious adverse events (SAEs), adverse events of special interest (AESIs), Eastern Cooperative Oncology Group performance status (ECOG PS), vital sign measurements, standard clinical laboratory parameters (hematology, clinical chemistry, and urinalysis), electrocardiogram parameters, echocardiogram (ECHO)/multigated acquisition (MUGA) scan findings, and ophthalmologic findings., Adverse events (AEs) will be coded by the most recent version of the Medical Dictionary for Regulatory Activities (MedDRA) and both AEs and laboratory test results will be graded by the National Cancer Institute-Common Terminology Criteria for Adverse Events (NCICTCAE) version 5.0., ADA prevalence: the proportion of subjects who are ADA-positive at any point in time (at baseline or post-baseline). ADA incidence: the proportion of subjects having a treatmentemergent ADA. Titer and neutralizing antibodies will be determined when the ADA is positive.

Source: https://euclinicaltrials.eu/ctis-public/view/2022-500802-16-00